EU clinical trial 2022-502118-10-00: A 3-Part Phase 1 Study to Investigate the Absolute Oral Bioavailability and Absorption, Metabolism, and Excretion of 14C-Unesbulin in Patients With Advanced Solid Tumor
Protocol code: PTC596-AME-101-AST
Sponsor: PTC Therapeutics Inc. (Pharmaceutical company). Phase: Human Pharmacology (Phase I)- Other. Countries: Hungary (ended).
Therapeutic area(s): Diseases [C] - Neoplasms [C04]
Gender: Female, Male. Age: 18-64 years, 65+ years. Enrolment: 12.
Status: Ended. Start date (EU): 2023-10-27. End date (EU): 2024-01-11. Decision date: 2023-04-17. Results received: Yes. Last updated: 2023-10-05.

Condition(s): Solid tumors
Product: Unesbulin, Unesbulin, Unesbulin, Unesbulin

Primary endpoint: Unesbulin plasma PK parameters including area under the plasma concentration-time curve (AUC), Cmax, Tmax, T1/2, systemic clearance, volume of distribution, elimination rate constant, and AOB, as feasible, Amount and percentage of radioactivity excreted in urine(Ae,u [mg-equiv] and fe,u [%]), feces (Ae,f [mg-equiv] and fe,f [%]), and total (Ae,total [mg-equiv] and fe,total [%]) for each interval and cumulative, and if produced, amount and percentage of radioactivity in emesis (Ae,e [mg-equiv] and fe,e [%]), PK parameters of 14C‑unesbulin- derived TRA in blood and plasma, unesbulin and its metabolites (if feasible) in plasma (area under the concentration-time curve from time 0 to the time of last quantifiable concentration [tlast] (AUC0-t), area under the concentration-time curve from time 0 extrapolated to infinity [AUC0-inf], Cmax, Tmax, T1/2, and AUC ratio of unesbulin or metabolites relative to plasma TRA, as applicable), Distribution of unesbulin and its metabolites in plasma, urine, and feces, as feasible
Endpoint(s): Vital signs and physical examinations, 12-Lead electrocardiogram (ECG), Clinical laboratory assessments, Adverse events (AEs), QT and corrected QT (QTc) interval extracted from Holter monitoring at the respective PK sampling timepoints up to 24 hours after oral dosing

Source: https://euclinicaltrials.eu/ctis-public/view/2022-502118-10-00